EU clinical trial 2025-522756-97-00: Randomized Open Label Trial Evaluating Efficacy and Safety of Intravenous Immunoglobulin (IVIg, Privigen) as Add-on to SoC Versus SoC Alone for Coronavirus Disease 2019 (COVID-19) in Patients with Severely Impaired B-cell Function
Protocol code: The CoVIg study
Sponsor: Region Vaesterbotten, Umea University (Hospital/Clinic/Other health care facility, Educational Institution). Phase: Therapeutic exploratory (Phase II). Countries: Sweden (authorised, recruitment pending).
Therapeutic area(s): Diseases [C] - Virus Diseases [C02]; Diseases [C] - Immune System Diseases [C20]
Gender: Female, Male. Age: 18-64 years, 65+ years. Enrolment: 92.
Status: Authorised, recruitment pending. Decision date: 2026-02-06. Results received: No. Last updated: 2026-02-06.

Condition(s): COVID-19 and Severely Impaired B-cell Function
Product: Privigen 100 mg/ml solution for infusion, Veklury 100 mg powder for concentrate for solution for infusion, Paxlovid 150 mg + 100 mg film-coated tablets, Paxlovid 150 mg + 100 mg film-coated tablets

Primary endpoint: Proportion of participants with clinical recovery (defined as a score of 0 or 1 according to the WHO Clinical Progression Scale) and no detectable SARS-CoV-2 RNA in blood plasma at Day 28, without receiving additional SARS-CoV-2 directed treatment (direct acting antivirals and/or IVIg) beyond SoC after randomization.
Endpoint(s): Proportion of participants with clinical improvement (defined as a reduced score of ≥1 according to the WHO clinical progression scale) and no detectable SARS-CoV-2 RNA in blood plasma at Day 10 after randomization, Proportion of participants with sustained clinical recovery (defined as a score of 0 or 1 according to the WHO Clinical Progression Scale) and no baseline SARS-CoV-2 straina RNA in blood plasma and nasopharyngeal sample at days 90 and 180, without additional SARS-CoV-2 directed treatment (direct acting antivirals and/or IVIg) beyond SoC after randomization., Ranked-based comparison of 10-category ordinal WHO Clinical Progression Scale score as assessed by the Investigator at days 10 and 28 AR, Proportion of participants with severe COVID-19 (defined as a score of ≥6 according to the WHO clinical progression scale) up to and by Day 28 after randomization., AEs/SAEs. Assessments related to AEs include: Occurrence/frequency, Relationship to the Investigational Medicinal Product (IMP) as assessed by the investigator, Intensity, Seriousness, Death, AEs leading to withdrawal from the study, Other significant AEs

Source: https://euclinicaltrials.eu/ctis-public/view/2025-522756-97-00